EU clinical trial 2022-502067-38-00: Effect of neoadjuvant Degarelix on MRI-guided transurethral ultrasound ablation in patients with intermediate-risk prostate cancer: A pilot study
Sponsor: Turku University Central Hospital (Hospital/Clinic/Other health care facility). Phase: Human Pharmacology (Phase I)- Other. Countries: Finland (ongoing, recruitment ended).
Therapeutic area(s): Diseases [C] - Male Urogenital Diseases [C12]
Gender: Male. Age: 18-64 years, 65+ years. Enrolment: 15.
Status: Ongoing, recruitment ended. Start date (EU): 2023-06-29. Decision date: 2023-03-21. Results received: No. Last updated: 2023-05-12.

Condition(s): Intermediate-risk prostate cancer
Product: FIRMAGON 80 mg powder and solvent for solution for injection

Primary endpoint: To measure prostate and tumor volume change after neoadjuvant ADT using T2-weighted MRI., To measure tumor-capsule contact length change after neoadjuvant ADT using T2-weighted MRI., To measure the change in vascular perfusion to the prostate and tumor after neoadjuvant ADT using dynamic contrast-enhanced T1-weighted MRI., To evaluate tissue structural changes after neoadjuvant ADT using quantitative analysis of the prostate’s intensity, shape, and texture on T2-weighted, quantitative T2 relaxation time mapping, and diffusion-weighted MRI., To measure thermal coverage of the target volume achieved by whole-gland TULSA by comparing physician-defined target boundaries to MRI measurements of temperature distributions, thermal dose distributions, and acute treatment-induced perfusion defect., To evaluate the subsequent safety, oncological, and quality-of-life outcomes of these patients for a period of 5 years.

Source: https://euclinicaltrials.eu/ctis-public/view/2022-502067-38-00